EU clinical trial 2024-516264-28-00: A Phase 3, Randomized, Open-Label, Multicenter Study to Evaluate the Safety, Efficacy and Pharmacokinetics of Ferumoxytol for the Treatment of Iron Deficiency Anemia (IDA) in Pediatric Subjects
Protocol code: AMAG-FER-IDA-352
Sponsor: Amag Pharmaceuticals Inc. (Pharmaceutical company). Phase: Therapeutic confirmatory (Phase III). Countries: Poland (ongoing, recruiting), Lithuania (ongoing, recruiting).
Therapeutic area(s): Diseases [C] - Nutritional and Metabolic Diseases [C18]
Gender: Female, Male. Age: 0-17 years. Enrolment: 51.
Status: Ongoing, recruiting. Start date (EU): 2019-09-03. Decision date: 2024-08-30. Results received: No. Last updated: 2024-09-13.
Decision dates by country: LT: 2024-09-13, PL: 2024-08-30

Condition(s): Iron Deficiency Anemia (IDA)
Product: Venofer 20 mg iron / ml, solution for injection or concentrate for solution for infusion., Ferumoxytol

Primary endpoint: Safety Endpoints: Incidence of adverse events of special interest (hypotension and hypersensitivity)., Incidence of serious adverse events (SAEs)., Incidence of severe adverse events (AEs)., Incidence of cardiovascular AEs (myocardial infarction, heart failure, moderate to severe hypertension, and hospitalization due to any cardiovascular cause)., Incidence of AEs leading to study drug discontinuation., Incidence of treatment emergent AEs (TEAEs)., Change in vital signs (BP, heart rate, respiration rate) and body temperature, and routine laboratory parameters (hematology, chemistry, and iron panel).
Endpoint(s): Efficacy Endpoints: Proportion of subjects achieving a Hgb increase of at least 0.5 g/dL from Baseline to Week 5., Proportion of subjects achieving a Hgb increase of at least 0.5 g/dL or TSAT increase of at least 10% from Baseline to Week 5., Proportion of subjects achieving a TSAT increase of at least 10% from Baseline to Week 5., Change in Hgb from Baseline to Week 5., Proportion of subjects achieving a Hgb increase of at least 1.0 g/dL from Baseline to Week 5., Change in TSAT from Baseline to Week 5., Proportion of subjects receiving blood transfusions during the study., Change in other markers of iron stores (e.g., serum ferritin and serum iron) from Baseline to Week 5., Pharmacokinetic Endpoints: Area Under the Curve (AUC)., Clearance., Distribution and elimination half-lives. All parameters will be obtained from the population model.

Source: https://euclinicaltrials.eu/ctis-public/view/2024-516264-28-00